EU clinical trial 2024-516924-32-00: A phase IIIb, Multicenter, Single-Arm Study Assessing the Effectiveness, Safety and Patient Reported Outcomes of a 36-week Refill Exchange Regimen for the Port Delivery System with Ranibizumab in Patients with Neovascular Age-Related Macular Degeneration
Protocol code: MR45625
Sponsor: F. Hoffmann-La Roche AG (Pharmaceutical company). Phase: Therapeutic confirmatory (Phase III). Countries: Italy (ongoing, recruiting), Germany (ongoing, recruiting), France (ongoing, recruiting), Spain (ongoing, recruiting), Czechia (ongoing, recruiting), Austria (ongoing, recruiting), Denmark (ongoing, recruiting), Greece (ongoing, recruiting), Poland (ongoing, recruiting).
Therapeutic area(s): Diseases [C] - Eye Diseases [C11]
Gender: Female, Male. Age: 18-64 years, 65+ years. Enrolment: 164.
Status: Ongoing, recruiting. Start date (EU): 2025-10-17. Decision date: 2025-08-22. Results received: No. Last updated: 2026-07-13.
Decision dates by country: GR: 2025-08-26, DK: 2025-08-22, FR: 2025-08-27, DE: 2025-08-26, IT: 2025-08-26, ES: 2025-08-27, CZ: 2025-08-26, AT: 2025-08-27, PL: 2025-08-26

Condition(s): Neovascular Age-Related Macular Degeneration (nAMD)
Product: RO4893594, RANIBIZUMAB

Primary endpoint: Change from baseline best-corrected visual acuity (BCVA) score as measured using the Early Treatment Diabetic Retinopathy Study (ETDRS) chart at a starting distance of 4 meters averaged over Weeks 68 and 72
Endpoint(s): Change from baseline in BCVA score over time (up to and including Week 72), Proportion of patients who lose ≤ 15, ≤ 10, ≤ 5, or gain ≥ 0 letters in BCVA score from baseline over time up to and including Week 72, Change from baseline in center point thickness (CPT) over time up to and including Week 72, Change from baseline in central subfield thickness (CST) over time up to and including Week 72, Proportion of participants who do not undergo supplemental treatment with IVT ranibizumab 0.5 mg before each refill-exchange procedure and overall up to and including Week 72, Number of supplemental treatments with IVT ranibizumab 0.5 mg patients received in each refill cycle and overall up to and including Week 72, Frequency of study visits in each refill cycle and overall up to and including Week 72, Proportion of patients who report preferring ranibizumab 100 mg/mL delivered via the PDS compared with IVT treatment, as measured by the PDS Patient Preference Questionnaire (PPPQ) at Weeks 24 and 72, Proportion of patients with bilateral disease who report preferring PDS compared with IVT treatment, as measured by the PPPQ at Weeks 24 and 72, Incidence and severity of ocular and systemic (non-ocular) adverse events, Incidence and severity of adverse events of special interest, including ocular adverse events of special interest, Incidence and severity of ocular adverse events of special interest during the postoperative period (≤ 37 days of initial implantation) and follow-up period ( > 37 days after implantation surgery), Incidence and severity of adverse device effects with PDS, Incidence, and severity of anticipated serious adverse device effects with PDS

Source: https://euclinicaltrials.eu/ctis-public/view/2024-516924-32-00